EU clinical trial 2023-504746-54-00: A PHASE 1B, MULTICENTER, RANDOMIZED, PLACEBO- CONTROLLED, DOUBLE-BLIND STUDY TO EVALUATE THE SAFETY, TOLERABILITY, AND BIOLOGICAL ACTIVITY OF TQS-168 IN SUBJECTS WITH AMYOTROPHIC LATERAL SCLEROSIS
Protocol code: TQS-168-ALS-101
Sponsor: Tranquis Therapeutics Inc. (Pharmaceutical company). Phase: Human Pharmacology (Phase I)- Other. Countries: Latvia (authorised, recruitment pending).
Therapeutic area(s): Diseases [C] - Nervous System Diseases [C10]
Gender: Female, Male. Age: 18-64 years, 65+ years. Enrolment: 16.
Status: Authorised, recruitment pending. Decision date: 2023-10-11. Results received: No. Last updated: 2023-10-11.

Condition(s): AMYOTROPHIC LATERAL SCLEROSIS

Source: https://euclinicaltrials.eu/ctis-public/view/2023-504746-54-00